EU clinical trial 2025-522335-34-00: (22597) A study to learn about how safe nitroglycerin is and how it affects the body when taken along with nurandociguat in people with coronary artery disease.
Protocol code: 22597
Sponsor: Bayer AG (Pharmaceutical company). Phase: Human Pharmacology (Phase I)- Other. Countries: Germany (authorised, recruitment pending), Bulgaria (authorised, recruitment pending).
Therapeutic area(s): Diseases [C] - Cardiovascular Diseases [C14]
Gender: Female, Male. Age: 18-64 years, 65+ years. Enrolment: 36.
Status: Authorised, recruitment pending. Decision date: 2026-01-22. Results received: No. Last updated: 2026-08-03.
Decision dates by country: DE: 2026-02-12, BG: 2026-02-12

Condition(s): Chronic kidney disease, Coronary artery disease

Source: https://euclinicaltrials.eu/ctis-public/view/2025-522335-34-00